EU clinical trial 2024-519535-42-00: A Phase 1/2, First-in-Human, Open-label, Assessor-Masked, Randomized, Controlled, Dose Escalation/Expansion Study to Evaluate the Safety, Tolerability and Preliminary Efficacy of a Subretinal Injection of SB-007 in Subjects with Stargardt Disease (STGD1) Caused by Bi-Allelic Autosomal Recessive Mutations in the ATP Binding Cassette Subfamily A Member 4 (ABCA4) Gene (ASTRA).
Protocol code: SB-007 CS-101
Sponsor: Splicebio S.L. (Pharmaceutical company). Phase: Phase I and Phase II (Integrated)- First administration to humans. Countries: Germany (ongoing, recruiting), Belgium (authorised, recruitment pending).
Therapeutic area(s): Diseases [C] - Eye Diseases [C11]
Gender: Female, Male. Age: 18-64 years. Enrolment: 13.
Start date (EU): 2026-05-26. Decision date: 2025-07-14. Results received: No. Last updated: 2026-05-07.
Decision dates by country: BE: 2026-05-06, DE: 2025-07-14

Condition(s): Stargardt Disease
Product: SB-007

Primary endpoint: The primary endpoint is safety and tolerability through Week 96 assessed by incidence and/or clinically significant changes in ocular and non-ocular adverse events (AEs).
Endpoint(s): 1. Change from baseline in lesion size growth (as measured by definitely decreased autofluorescence [DDAF]) on fundus autofluorescence (FAF) imaging compared between SB-007 and untreated control., 2. Change from baseline in lesion size growth (as measured by DDAF) on FAF imaging., 3.Change from baseline in total lesion size growth (as measured by DDAF and well demarcated questionably decreased autofluorescence (QDAF)) on FAF imaging., 4. Change from baseline in ellipsoid zone area as measured by spectral-domain optical coherence tomography (SD-OCT)., 5. Change from baseline in retinal sensitivity based on microperimetry., 6. Change from baseline in best-corrected visual acuity (BCVA) using Early Treatment Diabetic Retinopathy Study (ETDRS)., 7. Change from baseline in low luminance visual acuity (LLVA) using ETDRS., 8. Change from baseline in contrast sensitivity scores.

Source: https://euclinicaltrials.eu/ctis-public/view/2024-519535-42-00